EU clinical trial 2024-515258-25-00: A Phase 1/2, Multi-Center, Open-Label Study to Evaluate the Safety, Tolerability, Pharmacokinetics, and Preliminary Evidence of Antitumor Activity of JAB-21822 Monotherapy and Combination Therapy in Adult Patients with Advanced Solid Tumors Harboring KRAS G12C Mutation
Protocol code: JAB-21822-1001
Sponsor: Jacobio Pharmaceuticals Co. Ltd. (Pharmaceutical company). Phase: Phase I and Phase II (Integrated)- First administration to humans. Countries: Spain (ended).
Therapeutic area(s): Diseases [C] - Neoplasms [C04]
Gender: Female, Male. Age: 18-64 years, 65+ years. Enrolment: 111.
Status: Ended. End date (EU): 2024-12-27. Decision date: 2024-07-18. Results received: Yes. Last updated: 2024-11-18.

Condition(s): advanced solid tumors with KRAS G12C mutation
Product: JAB-21822

Primary endpoint: Dose Escalation Phase (Phase 1): Safety and tolerability of repeated cycles from first drug administration up to the end of the follow-up period; Incidence, nature, and severity of TEAEs, TRAEs, and death per NCI CTCAE v5, Dose Escalation Phase (Phase 1): Treatment-emergent changes in clinical laboratory measurements, ECG findings, vital signs, ECOG performance status, and physical examination findings, Dose Escalation Phase (Phase 1): Number and proportion of participants who experience at least 1 DLT during the first 21 days of treatment, Dose Expansion Phase (Phase 2): ORR defined as the percentage of participants with PR or CR based on RECIST v1.1, Dose Expansion Phase (Phase 2): DOR
Endpoint(s): Dose Escalation Phase (Phase 1): ORR defined as the percentage of participants with PR or CR based on RECIST v1.1, Dose Escalation Phase (Phase 1): DCR, TTR, DOR, and PFS, Dose Escalation Phase (Phase 1): PK parameters of JAB-21822 including, but not limited to, Cmax, tmax, Ctrough, AUC0-τ, AUC0-t, AUC0 inf, t½, CL/F, Vz/F, Rac Cmax, and Rac AUC, Dose Expansion Phase (Phase 2): PFS and TTR, Dose Expansion Phase (Phase 2): OS, Dose Expansion Phase (Phase 2): DCR, Dose Expansion Phase (Phase 2): Safety and tolerability of repeated cycles from first drug administration up to the end of the follow-up period; Incidence, nature, and severity of TEAEs, TRAEs, and death per NCI CTCAE v5, Dose Expansion Phase (Phase 2): Treatment-emergent changes in clinical laboratory measurements, ECG findings, vital signs, ECOG performance status, and physical examination findings, Dose Expansion Phase (Phase 2): PK parameters of JAB-21822 and potential factors (covariates) that impact the PK parameters

Source: https://euclinicaltrials.eu/ctis-public/view/2024-515258-25-00